EU clinical trial 2023-508661-33-00: A clinical study to assess if a new investigational medicinal product called JJP-1212 is safe, tolerable and able to induce a specific immune response in humans
Protocol code: JJP-1212-01-01
Sponsor: Jjp Biologics Sp. z o.o. (Pharmaceutical company). Phase: Human Pharmacology (Phase I)- First administration to humans. Countries: Poland (ongoing, recruiting), Bulgaria (authorised, recruitment pending).
Therapeutic area(s): Diseases [C] - Musculoskeletal Diseases [C05]; Diseases [C] - Immune System Diseases [C20]; Diseases [C] - Skin and Connective Tissue Diseases [C17]
Gender: Female, Male. Age: 18-64 years, 65+ years. Enrolment: 76.
Start date (EU): 2024-05-29. Decision date: 2024-05-27. Results received: No. Last updated: 2026-06-19.
Decision dates by country: BG: 2025-10-13, PL: 2024-05-27

Condition(s): Rheumatoid Arthritis, Linear IgA dermatosis (LAD)

Source: https://euclinicaltrials.eu/ctis-public/view/2023-508661-33-00